EU clinical trial 2025-521936-12-00: A Placebo-Controlled, Double-Blind, Randomized, Phase 3 Study to Evaluate the Effect of Obicetrapib 10 mg and Ezetimibe 10 mg Fixed-Dose Combination or Obicetrapib 10 mg Daily on Top of Guideline-Recommended Lipid-Lowering Therapy in Participants With Type 2 Diabetes and/or Metabolic Syndrome (RUBENS trial)
Protocol code: OBEZ-303
Sponsor: NewAmsterdam Pharma B.V. (Pharmaceutical company). Phase: Therapeutic confirmatory (Phase III). Countries: Czechia (ongoing, recruiting), Slovakia (ongoing, recruiting), Netherlands (ongoing, recruiting).
Therapeutic area(s): Diseases [C] - Cardiovascular Diseases [C14]
Gender: Female, Male. Age: 18-64 years, 65+ years. Enrolment: 118.
Status: Ongoing, recruiting. Start date (EU): 2026-04-24. Decision date: 2026-03-31. Results received: No. Last updated: 2026-06-30.
Decision dates by country: SK: 2026-04-01, NL: 2026-03-31, CZ: 2026-03-31

Condition(s): Adults with Type 2 Diabetes and/or Metabolic Syndrome on guideline recommended lipid lowering therapy and elevated low-density lipoprotein cholesterol (LDL-C)
Product: Placebo matching Obicetrapib 10 mg + ezetimibe 10 mg fixed dose combination (FDC) tablets, Obicetrapib, Obicetrapib 10 mg + ezetimibe 10 mg fixed dose combination (FDC), Placebo matching Obicetrapib 10 mg tablets

Primary endpoint: The percent change from Baseline to Day 84 in LDL-C compared with placebo for the following treatment groups: • obicetrapib 10 mg + ezetimibe 10 mg FDC treatment group; and • obicetrapib 10 mg monotherapy treatment group, The percent change from Baseline to Day 84 in LDL-C for obicetrapib 10 mg + ezetimibe 10 mg FDC treatment group compared with the obicetrapib 10 mg monotherapy treatment group
Endpoint(s): Percent change from Baseline to Day 84 in non-HDL-C for the obicetrapib 10 mg + ezetimibe 10 mg FDC treatment group compared with the placebo group, Percent change from Baseline to Day 84 in HDL-C for the obicetrapib 10 mg + ezetimibe 10 mg FDC treatment group compared with the placebo group, Percent change from Baseline to Day 84 in ApoB for the obicetrapib 10 mg + ezetimibe 10 mg FDC treatment group compared with the placebo group, Percent change from Baseline to Day 84 in ApoA1 for the obicetrapib 10 mg + ezetimibe 10 mg FDC treatment group compared with the placebo group, Percent change from Baseline to Day 84 in non-HDL-C for the obicetrapib 10 mg monotherapy treatment group compared with the placebo group, Percent change from Baseline to Day 84 in HDL-C for the obicetrapib 10 mg monotherapy treatment group compared with the placebo group, Percent change from Baseline to Day 84 in ApoB for the obicetrapib 10 mg monotherapy treatment group compared with the placebo group, Percent change from Baseline to Day 84 in ApoA1 for the obicetrapib 10 mg monotherapy treatment group compared with the placebo group, Percent change from Baseline to Day 84 in lipoprotein (a) (Lp[a]) for the obicetrapib 10 mg + ezetimibe 10 mg FDC treatment group compared with the placebo group, Percent change from Baseline to Day 84 in Lp(a) for the obicetrapib 10 mg monotherapy treatment group compared with the placebo group, Exploratory: Proportion of participants at Day 84 that achieve LDL-C <100 mg/dL (<2.6 mmol/L), LDL--C <70 mg/dL (<1.8 mmol/L), and LDL-C <55 mg/dL (<1.4 mmol/L) for the obicetrapib 10 mg + ezetimibe 10 mg FDC treatment group compared with the placebo group and for the obicetrapib 10 mg monotherapy treatment group compared with the placebo group, Exploratory: Percent change from Baseline to Day 84 in particle numbers and size, as measured by NMR analysis, of LDL-C, HDL-C, and VLDL-C for the obicetrapib 10 mg + ezetimibe 10 mg FDC treatment group compared with the placebo group and for the obicetrapib 10 mg monotherapy treatment group compared with the placebo group, Exploratory: Percent change from Baseline to Day 84 in sdLDL-C for the obicetrapib 10 mg + ezetimibe 10 mg FDC treatment group compared with the placebo group and for the obicetrapib 10 mg monotherapy treatment group compared with the placebo group, Exploratory: Percent change from Baseline to Day 84 in HbA1c for the obicetrapib 10 mg + ezetimibe 10 mg FDC treatment group compared with the placebo group and for the obicetrapib 10 mg monotherapy treatment group compared with the placebo group, OLE exploratory efficacy endpoints are assessed from Baseline at every visit for the following parameters: • Percent change from Baseline over time in LDL-C; • Proportion of participants that achieve LDL-C <100 mg/dL (<2.6 mmol/L), LDL-C <70 mg/dL (<1.8 mmol/L), and LDL-C <55 mg/dL (<1.4 mmol/L); • Percent change from Baseline over time in non-HDL-C, ApoB, total cholesterol, triglycerides, HDL-C, Lp(a)

Source: https://euclinicaltrials.eu/ctis-public/view/2025-521936-12-00